EU clinical trial 2024-513648-27-00: SCLERITA - Safety and efficacy of itacitinib in adults with systemic sclerosis: a phase II, randomized, controlled trial
Protocol code: APHP180613
Sponsor: Assistance Publique Hopitaux De Paris (Hospital/Clinic/Other health care facility). Phase: Therapeutic exploratory (Phase II). Countries: France (ended).
Therapeutic area(s): Diseases [C] - Immune System Diseases [C20]
Gender: Female, Male. Age: 18-64 years, 65+ years. Enrolment: 74.
Status: Ended. Start date (EU): 2024-10-25. End date (EU): 2025-11-20. Decision date: 2024-07-30. Results received: No. Last updated: 2025-08-12.

Condition(s): Patients with newly or active diffuse Systemic sclerosis (SSc) at the time of screening
Product: Itacitinib, placebo of itacitinib 100mg

Primary endpoint: The primary outcome is the change in modified Rodnan skin score at 360 days
Endpoint(s): Security profile; SSc disease activity; Quality of life and disability

Source: https://euclinicaltrials.eu/ctis-public/view/2024-513648-27-00